EU clinical trial 2022-500100-21-01: Phase II multicenter clinical trial: Mosunetuzumab for early relapse of follicular lymphoma in the Nordic countries (MERLIN/NLG-FL6/ML43841)
Sponsor: Oslo University Hospital Hf (Hospital/Clinic/Other health care facility). Phase: Therapeutic exploratory (Phase II). Countries: Finland (ongoing, recruitment ended), Norway (ongoing, recruitment ended), Denmark (ongoing, recruitment ended), Sweden (ongoing, recruitment ended).
Therapeutic area(s): Diseases [C] - Hemic and Lymphatic Diseases [C15]; Diseases [C] - Neoplasms [C04]
Gender: Female, Male. Age: 18-64 years, 65+ years. Enrolment: 80.
Status: Ongoing, recruitment ended. Start date (EU): 2023-09-11. Decision date: 2023-02-07. Results received: No. Last updated: 2025-11-10.
Decision dates by country: NO: 2023-02-10, FI: 2023-02-10, SE: 2023-02-08, DK: 2023-02-07

Condition(s): Follicular lymphoma
Product: Mosunetuzumab, Mosunetuzumab

Primary endpoint: Progression free survival (within an observation time of a minimum of two years and a maximum of four years depending on the timepoint of patient inclusion in the trial
Endpoint(s): Complete response rate (CRR) by FDG-PET-CT to 8 cycles of mosunetuzumab, Overall response rate (ORR) by FDG-PET-CT to 8 cycles of mosunetuzumab, Best CRR and ORR (by CT) to all administered cycles of mosunetuzumab, CRR and ORR (by CT) at 30 months after start of treatment, Duration of response (DOR) from the first occurrence of documented response by FDG-PET-CT to disease progression or death of any cause., Time to new lymphoma treatment (from inclusion to the start of treatment other than mosunetuzumab due to progression of disease or to death of any cause)., PFS stratified by type of first line treatment (R monotherapy versus R combined with chemotherapy or other agents)., PFS by FDG-PET-CT response groups according to the 2014 Lugano Classification (from inclusion to the first occurrence of disease progression as determined by investigator or death from any cause)., Overall survival (OS) from inclusion to death of any cause., Safety and tolerability of treatment, as the percentage of patients with adverse events (AEs) and the rate of dropout due to AEs., Histology at relapse or progression occurring after or during study treatment., Rate of transformation to higher-grade lymphoma., Resource usage during treatment such as the rate of hospitalizations and duration of hospitalizations due to mosunetuzumab treatment and/or AEs and the number of out-patient consultations due to mosunetuzumab treatment and/or AEs., Quality of life during and after treatment (as measured by EORTC QLQ-C30 and by EQ-5D).

Source: https://euclinicaltrials.eu/ctis-public/view/2022-500100-21-01